EU clinical trial 2023-504309-35-00: Evaluation and promotion of specific adaptative immunity against polyomavirus (BKV) to prevent viral infection after kidney transplantation (BK-VAX project)
Protocol code: BK-VAX
Sponsor: Fir Huvh Fundacio Institut De Recerca Hospital Universitari Vall De Hebron (Laboratory/Research/Testing facility). Phase: Therapeutic use (Phase IV). Countries: Spain (expired).
Therapeutic area(s): Diseases [C] - Virus Diseases [C02]; Phenomena and Processes [G] - Immune system processes [G12]
Gender: Female, Male. Age: 18-64 years, 65+ years. Enrolment: 70.
Status: Expired. Decision date: 2023-06-15. Results received: No. Last updated: 2023-06-15.

Condition(s): Prevention viral infection (BKV) poliamavirus after kidney trasplantation
Product: Myfortic 360 mg Comprimidos gastrorresistentes, CellCept 250 mg capsules, CellCept 500 mg film-coated tablets, Rapamune 1 mg coated tablets, Myfortic 180 mg comprimidos gastrorresistentes

Primary endpoint: changes in immune response virus-specific at different biological levels, of patients who develop infection virus by the BK virus through the changes in BK virus viral load in peripheral blood of patients
Endpoint(s): Differences between groups of the specific effector polyfunctional T (IFN-y/IL2, IL-2, IFN-y, IL6, IL-4) response against different proteins VBK (LT-1, VP1) using FluorSPOT technique, Differences Between Groups in Memory B Cell Response producer of specific IgG against BKV immunogenic proteins, Differences between specific neutralizing antibodies (NAb), by using a system based on pseudovirions that express genotypes I-IV virus capsid proteins, Differences in the specific immunophenotype by FACS multiparameter spectral analysis (AURORA, CyTEX Bioscience) of cells CD8+, CD4+ and NKT with special interest in exhaustion phenotypes that could be induced by using mTor-i (CD45RA and CD27; CD85j, CD161, CD16, CD56 CD161 and CD94 and KLRG1; or PD-1, TIM-3, LAG3, and DNAM-1)., Differences in TCR signaling efficiency of cells Specific T against BKV

Source: https://euclinicaltrials.eu/ctis-public/view/2023-504309-35-00